EU clinical trial 2025-521608-23-00: A PHASE 2 STUDY OF STRIDE (durvalumab + tremelimumab) With Lenvatinib Versus STRIDE Alone in Patients With Unresectable Hepatocellular Carcinoma (SLIDE-HCC) - HE.2
Protocol code: HE.2
Sponsor: IRCCS Istituto Nazionale Tumori Fondazione Pascale (Hospital/Clinic/Other health care facility). Phase: Therapeutic exploratory (Phase II). Countries: Italy (authorised, recruitment pending).
Therapeutic area(s): Diseases [C] - Neoplasms [C04]
Gender: Female, Male. Age: 18-64 years, 65+ years. Enrolment: 56.
Status: Authorised, recruitment pending. Decision date: 2026-06-12. Results received: No. Last updated: 2026-06-12.

Condition(s): patients with unrestectable hepatocellular carcinoma (SLIDE-HCC)
Product: TREMELIMUMAB, DURVALUMAB, LENVIMA 4 mg hard capsules

Primary endpoint: PFS (Progression-Free Survival)
Endpoint(s): OS (Overall Survival) -ORR (Objective Response Rate) -Safety - Toxicity

Source: https://euclinicaltrials.eu/ctis-public/view/2025-521608-23-00